EU clinical trial 2023-510402-40-00: MK-7091 Formulations Study in Healthy Adult Participants
Protocol code: MK-7091-003
Sponsor: Merck Sharp & Dohme LLC (Pharmaceutical company). Phase: Human Pharmacology (Phase I)- Other. Countries: Belgium (ended).
Therapeutic area(s): Diseases [C] - Cardiovascular Diseases [C14]
Gender: Female, Male. Age: 18-64 years. Enrolment: 36.
Status: Ended. Start date (EU): 2024-06-07. End date (EU): 2025-01-02. End date: 2025-01-03. Decision date: 2024-06-04. Results received: No. Last updated: 2024-09-04.

Condition(s): Hypercholesterolemia

Source: https://euclinicaltrials.eu/ctis-public/view/2023-510402-40-00